EU clinical trial 2023-503703-28-00: A comparative bioavailability of reformulated ibuprofen 2% and 4% oral suspensions (Berlin Chemie AG) and reference ibuprofen (Nurofen®) 200 mg/5 ml oral suspension in healthy male and female adult subjects under fasting conditions: an open-label, randomized, single-dose, three-period, three-treatment, three-sequence crossover study
Protocol code: BCLT/22/IBU-BE/001
Sponsor: Berlin-Chemie AG (Pharmaceutical company). Phase: Human Pharmacology (Phase I)- Bioequivalence Study. Countries: Lithuania (ended).
Therapeutic area(s): Not possible to specify
Gender: Female, Male. Age: 18-64 years. Enrolment: 75.
Status: Ended. Start date (EU): 2023-10-25. End date (EU): 2024-04-02. Decision date: 2023-08-24. Results received: No. Last updated: 2024-04-16.

Condition(s): In this study will be no subjects involved with any specific medical condition or disease

Source: https://euclinicaltrials.eu/ctis-public/view/2023-503703-28-00